EU clinical trial 2023-509462-38-00: Prevention of opioid-induced constipation in patients with advanced cancer.
Protocol code: 08440012010002
Sponsor: Amsterdam UMC (Hospital/Clinic/Other health care facility). Phase: Phase III and phase IV (Integrated). Countries: Netherlands (ongoing, recruiting).
Therapeutic area(s): Diseases [C] - Neoplasms [C04]
Gender: Female, Male. Age: 18-64 years, 65+ years. Enrolment: 250.
Status: Ongoing, recruiting. Start date (EU): 2022-10-25. Decision date: 2024-10-28. Results received: No. Last updated: 2025-07-17.

Condition(s): Patients with advanced cancer.
Product: Magnesiumhydroxide Teva 724 mg, kauwtabletten, Movicolon Naturel 13,7 g, poeder voor drank

Primary endpoint: The primary endpoint is constipation, defined as the percentage of patients with a score of <30 of the Bowel Function Index, measured on day 14.
Endpoint(s): Change of the Bowel Function Index Score between day 0 and day 14;, Quality of life;, Rome IV criteria for opioid-induced constipation as judged by professional care givers;, Cancer pain score;, Side effects of laxatives;, Cost-effectiveness of macrogol/electrolytes compared to magnesium hydroxide;, Patient satisfaction with laxative.

Source: https://euclinicaltrials.eu/ctis-public/view/2023-509462-38-00